EU clinical trial 2023-503797-21-00: A Phase 3, Randomized, Open-label Study of Relatlimab-nivolumab Fixeddose Combination Versus Regorafenib or Trifluridine + Tipiracil (TAS-102) for Participants with Later-lines of Metastatic Colorectal Cancer
Protocol code: CA224-123
Sponsor: Bristol Myers Squibb International Corporation (Pharmaceutical company). Phase: Therapeutic confirmatory (Phase III). Countries: Belgium (ended), Spain (ended), France (ended), Czechia (ended), Sweden (ended), Netherlands (ended), Italy (ended), Germany (ended), Austria (ended), Poland (ended).
Therapeutic area(s): Diseases [C] - Neoplasms [C04]
Gender: Female, Male. Age: 18-64 years, 65+ years. Enrolment: 233.
Status: Ended. Start date (EU): 2022-08-10. End date (EU): 2025-07-14. End date: 2025-07-15. Decision date: 2023-12-13. Results received: Yes. Last updated: 2025-06-26.
Decision dates by country: AT: 2024-02-05, SE: 2023-12-18, NL: 2023-12-14, CZ: 2023-12-14, ES: 2023-12-15, FR: 2023-12-13, IT: 2023-12-21, DE: 2023-12-22, BE: 2023-12-15, PL: 2024-05-20

Condition(s): Metastatic Colorectal Cancer
Product: Lonsurf 15 mg/6.14 mg film-coated tablets, Relatlimab + Nivolumab Fixed Dose Combination (FDC), Lonsurf 20 mg/8.19 mg film-coated tablets, Stivarga 40 mg film-coated tablets

Primary endpoint: Overall Survival (OS) in randomized participants with PD-L1 CPS (combined positive score;) ≥ 1, OS in all randomized participants
Endpoint(s): ORR (objective response rate) by BICR (blinded independent central review) per RECIST v1.1 in randomized participants with PD-L1 CPS ≥ 1 and all randomized participants, respectively, PFS (progression-free survival) by BICR per RECIST v1.1 in randomized participants with PD-L1 CPS≥ 1 and all randomized participants, respectively, DoR (duration of response;) by BICR per RECIST v1.1 in responders with PD-L1 CPS ≥ 1 and all responders, respectively, Rate of AEs (adverse events), SAEs (serious adverse events), select AEs and IMAEs (immune-mediated adverse events), AEs leading to discontinuation and abnormalities in specific clinical laboratory assessments, QoLTUDD-physical function (TUDDPF), which is defined as time from randomization until definitive deterioration in the EORTC QLQ-C30 physical function scale score in randomized participants with PD-L1 CPS ≥ 1 and all randomized participants, respectively, TUDD-quality of life (TUDD-QoL), which is defined as time until definitive deterioration in the EORTC QLQ-C30 global health status/QoL scale score in randomized participants with PD-L1 CPS ≥ 1 and all randomized participants, Respectively, PFS, ORR, DoR by investigator per RECIST v1.1 in randomized participants with PD-L1 CPS = 1 and all randomized participants, respectively

Source: https://euclinicaltrials.eu/ctis-public/view/2023-503797-21-00